EU clinical trial 2022-502289-25-00: A Phase III, Randomized, Double-blind, Parallel-group, Placebo controlled Study to Evaluate the Pharmacokinetics, Pharmacodynamics, Efficacy, and Safety of IV Anifrolumab in Pediatric Participants 5 to < 18 Years of Age with Moderate to Severe Active Systemic Lupus Erythematosus While on Background Standard of Care Therapy
Protocol code: D3461C00030
Sponsor: AstraZeneca AB (Pharmaceutical company). Phase: Therapeutic confirmatory (Phase III). Countries: Germany (ongoing, recruiting), Spain (ongoing, recruiting), Italy (authorised, recruiting), Portugal (not authorised), France (authorised, recruiting), Poland (ongoing, recruiting).
Therapeutic area(s): Diseases [C] - Immune System Diseases [C20]
Gender: Female, Male. Age: 0-17 years. Enrolment: 20.
Start date (EU): 2024-08-28. Decision date: 2023-11-06. Results received: No. Last updated: 2026-08-03.
Decision dates by country: PT: 2023-11-08, FR: 2023-11-10, PL: 2023-11-10, DE: 2023-11-08, IT: 2023-11-08, ES: 2023-11-06

Condition(s): Moderate to Severe Active Systemic Lupus Erythematosus
Product: No active ingredient. The Placebo contains L-histidine, L-histidine hydrochloride monohydrate, L-lysine hydrochloride, trehalose dihydrate, and polysorbate 80. There are no preservatives or novel excipients included in the Placebo., Saphnelo 300 mg concentrate for solution for infusion

Primary endpoint: After single dose or after dose adjustment: • Serum PK concentrations PK parameters: Cmax, AUC, Cmin after the first dose or after dose adjustment, BICLA responders at W52 (Y/N), defined as follow: Reduction of all baseline BILAG A to B/C/D & B to C/D & no BILAG worsening in other organ systems (≥ 1 new BILAG A or ≥ 2 new BILAG B) No worsening from baseline S-2K (increase of > 0 points) No worsening from baseline in SLE activity (increase ≥ 0.30 points on a PGA 3-point VAS)
Endpoint(s): SRI(4) responders at Wk. 52 (Y/N): meet all the following: Minimum 4-point reduction from baseline (BL) SLEDAI2K score No new BILAG-2004 (BILAG) scores from BL (≥ 1 new A or ≥ 2 new BILAG B scores) No worsening in BL lupus disease activity (increase ≥ 0.30 points on a PGA 3-point VAS), Time to first flare through Week 52, where flare is defined as either ≥ 1 new BILAG-2004 A, or ≥ 2 new BILAG-2004 B items compared with the previous visit., • PK: Anifrolumab serum concentrations • Immunogenicity: ADA • PD: Change from baseline through Week 52 in: o Anti-dsDNA antibodies o C3, C4, and CH50 complement levels o Type I IFN 21-gene signature, Participants who are PRINTO/ACR cSLE responders (Y/N) at W52, defined as at least 50% improvement from baseline in any 2 of 5 core set outcome measures and no more than one of the remaining worsening > 30%, Reduction of OCS background dose from baseline through Week 52

Source: https://euclinicaltrials.eu/ctis-public/view/2022-502289-25-00